EU clinical trial 2024-511176-32-00: A Phase 2a Study of TPN-101 in Patients with Aicardi-Goutières Syndrome (AGS)
Protocol code: TPN-101-AGS-201
Sponsor: Transposon Therapeutics Inc. (Pharmaceutical company). Phase: Therapeutic exploratory (Phase II). Countries: France (ended), Italy (ended).
Therapeutic area(s): Diseases [C] - Nervous System Diseases [C10]
Gender: Female, Male. Age: 0-17 years, 18-64 years. Enrolment: 52.
Status: Ended. Start date (EU): 2023-01-27. End date (EU): 2025-02-27. End date: 2025-02-28. Decision date: 2024-09-12. Results received: No. Last updated: 2025-03-21.
Decision dates by country: FR: 2024-09-12, IT: 2024-10-16

Condition(s): Aicardi-Goutières Syndrome (AGS)
Product: censavudine

Primary endpoint: Reduction in innate immune signaling, as assessed by the expression of 24 ISG, used to calculate an IFN score in whole blood., Incidence and severity of treatment-emergent adverse events (TEAEs) with TPN-101 administered for up to 48 weeks in patients with AGS.
Endpoint(s): Concentrations of TPN-101 in plasma and cerebrospinal fluid (CSF), L1 expression including L1 RNA, IFN levels in blood and CSF, including IFN-alpha and IFN-gamma, and genome-wide RNA-Seq expression analysis in whole blood, Other inflammatory biomarkers in blood and CSF (e.g., neopterin), Neurodegeneration biomarkers, including NfL, UCHL-1, tau, and GFAP in blood and CSF, Brain magnetic resonance imaging (MRI) including arterial spin labeling for measurement of cerebral blood flow, Clinical and functional status, as measured by Vineland-3, AGS Scale, Caregiver Diary Score, BSID III, WPPSI-IV, WISC-V, WAIS-IV, GMFM-88, and classification according to 5 systems: GMFCS, MACS, CFCS, EDACS, and VFCS

Source: https://euclinicaltrials.eu/ctis-public/view/2024-511176-32-00